EU clinical trial 2023-508275-37-00: A Phase II, Open-label, Multi-centre Study to Evaluate Safety, Tolerability, Efficacy, PK, and Immunogenicity of AZD0901 as Monotherapy and in Combination with Anti-cancer Agents in Participants with Advanced Solid Tumours Expressing Claudin 18.2 (CLARITY-PanTumour01)
Protocol code: CLARITY-PT01
Sponsor: AstraZeneca AB (Pharmaceutical company). Phase: Phase I and Phase II (Integrated)- Other. Countries: Spain (ongoing, recruiting), Poland (ongoing, recruiting).
Therapeutic area(s): Diseases [C] - Neoplasms [C04]
Gender: Female, Male. Age: 18-64 years, 65+ years. Enrolment: 9.
Status: Ongoing, recruiting. Start date (EU): 2024-11-11. Decision date: 2024-09-06. Results received: No. Last updated: 2026-03-18.
Decision dates by country: PL: 2024-09-06, ES: 2024-09-09

Condition(s): Gastric Cancer, Gastroesophageal Junction Cancer, Pancreatic Ductal Adenocarcinoma, Biliary Tract Cancer
Product: BENDAFOLIN 10 mg/ml Injektionslösung, Gemcitabin HEXAL® 40 mg/ml Konzentrat zur Herstellung einer Infusionslösung, Benda-5 FU 50 mg/ml Injektionslösung, Onivyde pegylated liposomal 4.3 mg/ml concentrate for dispersion for infusion, Irinotecan Bendalis 20 mg/ml Konzentrat zur Herstellung einer Infusionslösung, AZD0901

Primary endpoint: Incidence of AEs and SAEs, Changes form baseline in laboratory parameters, vital signs, ECGs, and physical examination, Rate of AEs leading to discontinuation of AZD0901, Occurrence of DLTs (Japanese safety cohort in sub study 1, and safety run-in in sub study 2), Proportion of participants with a confirmed Complete Response (CR) or Partial Response (PR) as determined by the Investigator at local site as per RECIST v1.1
Endpoint(s): Overall Survival - The time from date of first dose/randomisation until the date of death due to any cause, Progression-free survival is defined as the time from first dose/date of randomisation until progression per RECIST v1.1 asassessed by the Investigator at local site, or death due to any cause, regardless of whether the participant withdraws from randomized therapy, receives another anti-cancer therapy or clinically progresses prior to RECIST v1.1 progression., DoR - The time from the date of first documented confirmed response until date of first documented progression per RECISTv1.1 or death due to any cause., TTR - The time from first dose/date of randomisation until the first documentation of a subsequently confirmed objective response per RECIST v1.1 as assessed by the Investigator at local site., DCR at 12 weeks is defined as the percentage of participants who have a confirmed CR or PR or who have SD per RECIST v1.1as assessed by the Investigator at local site and derived from the raw tumour data for at least 11 weeks after date of first dose/date of randomisation., Tumor Size - The best percentage change from baseline in tumor size is the largest decrease (or smallest increase) from baseline for a participant, using RECIST v1.1 assessments., To characterise the PK of AZD0901 monotherapy or in combination with anti cancer agents in participants with advancedor metastatic solid tumours expressing CLDN18.2., To determine the immunogenicity of AZD0901 monotherapy or in combination with anti-cancer agents in participants with advanced or metastatic solid tumours expressing CLDN18.2., To investigate baseline and/or on-treatment tissue-based RNA,DNA, and/or proteins, and association with clinical activity ofAZD0901 (substudy 1)., DRR-12: DRR-12 is defined as the percentage of subjects with a durable response at 12 weeks. DRR-24: DRR-24 is defined as the percentage of subjects with a durable response at 24 weeks.

Source: https://euclinicaltrials.eu/ctis-public/view/2023-508275-37-00